EU clinical trial 2025-523115-11-00: A study to compare the Pharmacokinetics, Pharmacodynamic, Immunogenicity, and Safety of CKD-706 with US-Dupixent®, and EU-Dupixent® in Healthy Adult Participants.
Protocol code: A160_01AD2502
Sponsor: Chong Kun Dang Pharmaceutical Corp. (Pharmaceutical company). Phase: Human Pharmacology (Phase I)- First administration to humans. Countries: Germany (ongoing, recruiting).
Therapeutic area(s): Diseases [C] - Immune System Diseases [C20]
Gender: Female, Male. Age: 18-64 years. Enrolment: 335.
Status: Ongoing, recruiting. Start date (EU): 2026-01-14. Decision date: 2026-01-09. Results received: No. Last updated: 2026-07-30.

Condition(s): Phase I study in healthy participants. Intended indication: atopic dermatitis, asthma, chronic rhinosinusitis with nasal polyposis, eosinophilic esophagitis, prurigo nodularis, and chronic obstructive pulmonary disease

Source: https://euclinicaltrials.eu/ctis-public/view/2025-523115-11-00